EU clinical trial 2024-516937-10-01: Safe Stop Trial: observational study of the STOP & GO strategy of PD-1 blockade in advanced melanoma patients upon achieving a complete or partial response
Protocol code: Safe Stop
Sponsor: Erasmus Universitair Medisch Centrum Rotterdam (Erasmus MC) (Hospital/Clinic/Other health care facility). Phase: Therapeutic confirmatory (Phase III). Countries: Netherlands (ongoing, recruiting).
Therapeutic area(s): Diseases [C] - Skin and Connective Tissue Diseases [C17]
Gender: Female, Male. Age: 18-64 years, 65+ years. Enrolment: 200.
Status: Ongoing, recruiting. Start date (EU): 2024-12-18. Decision date: 2024-12-18. Results received: No. Last updated: 2025-08-05.

Condition(s): Melanoma
Product: KEYTRUDA 25 mg/mL concentrate for solution for infusion, OPDIVO 10 mg/mL concentrate for solution for infusion.

Primary endpoint: The primary endpoint of this study is the rate of ongoing responses (CR and PR) according to RECIST v1 .1 (35) at 24 months after first start of nivolumab/pembrolizumab
Endpoint(s): 1a. Total duration of tumor response after first documented CR or PR followed by treatment interruption, 1 b. Duration of tumor response (CR and PR) after discontinuation of PD-1 blockade, 2. PFS from start of first-line monotherapy with PD-1 blockade (i.e. nivolumab or pembrolizumab) until first PD (PFS1), 3a. Rate of reintroduction of monotherapy with PD-1 blockade (i.e. nivolumab or pembrolizumab) upon first PD, 3b. Rate of introduction of other systemic salvage therapy (i.e. other than monotherapy PD-1 blockade) upon first PD, 4a. Best tumor response on rechallenge with monotherapy PD-1 blockade (i.e. nivolumab or pembrolizumab), 4b. Best tumor response after introduction of other systemic salvage therapy (i.e. other than monotherapy PD-1 blockade), Sa. PFS after reintroduction of monotherapy PD-1 blockade (i.e. nivolumab, or pembrolizumab) (PFS2a), Sb. PFS after introduction other systemic salvage therapy (i.e. other than monotherapy PD- 1 blockade) (PFS2b), 6a. Total PFS (PFSTata1) defined as the period from initial start of PD-1 blockade until final PD (including period after discontinuation and (re-)introduction of nivolumab/ pembrolizumab or other salvage therapy), Totale PFS gedefinieerd als de periode vanaf de eerste start van PD-1-blokkering tot de uiteindelijke PD (inclusief periode na staken en bij (her)start van nivolumab/pemprolizumab of andere systemische therapie (PFStotaal), 7. Rate of grade 3-4 AEs after early discontinuation or reintroduction of nivolumab/pembrolizumab monotherapy, 8. Change in tumor burden since the start and after early discontinuation of PD-1 blockade, 9. Change in Qol after discontinuation of PD-1 blockade measured at different time point, 10. Change in fear of disease recurrence/progression, Change in productivity (paid and unpaid work) after discontinuation of PD-1 blockad, 12. Change in healthcare resource (within and outside the hospital) after discontinuation of PD-1 blockade, 13. Change in hours of informal care after discontinuation of PD-1 blockade, Qol at disease progression and restart of systemic therapy (when applicable), 14. Verandering in Qol bij PD en herstart systemlsche theraple (indien van toepassing)

Source: https://euclinicaltrials.eu/ctis-public/view/2024-516937-10-01